EU clinical trial 2023-510257-42-01: DiEtary Sodium Intake effects on ertugliflozin-induced changes in GFR, reNal oxygenation and systemic hemodynamics: the DESIGN study, a randomized, placebo-controlled, cross-over study with ertugliflozin in people with type 2 diabetes.
Sponsor: Amsterdam UMC (Hospital/Clinic/Other health care facility). Phase: Therapeutic use (Phase IV). Countries: Netherlands (ended).
Therapeutic area(s): Diseases [C] - Nutritional and Metabolic Diseases [C18]
Gender: Female, Male. Age: 65+ years. Enrolment: 17.
Status: Ended. Start date (EU): 2023-07-25. End date (EU): 2025-11-30. Decision date: 2024-10-03. Results received: No. Last updated: 2025-07-22.

Condition(s): Type 2 diabetes
Product: Steglatro 15 mg film-coated tablets

Primary endpoint: To investigate the modifying effects of WHO-recommended sodium intake (90 mmol per day) vs. high sodium intake (targeted at 250 mmol per day) on the effect of ertugliflozin 15 mg daily, versus placebo, on 24-hour blood pressure in overweight/obese adults with type 2 diabetes.
Endpoint(s): GFR by iohexol clearance • Hematocrit • Office blood pressure • Kidney oxygenation • Parameters of intra kidney hemodynamic function including ERPF by p-aminohippurate (PAH) clearance and renal vascular resistance • Body anthropometrics • Fasting plasma glucose • Albumin excretion rate (24 hour) • 24-hr urinary glucose excretion • Urinary and plasma biomarkers

Source: https://euclinicaltrials.eu/ctis-public/view/2023-510257-42-01